EU clinical trial 2024-513938-38-00: An open-label dose-escalation study evaluating the safety, pharmacokinetics and antiviral activity of IMC-M113V in HLA-A*2:01 positive subjects with chronic HIV infection who are virologically suppressed.
Protocol code: IMC-M113V-103
Sponsor: Immunocore Limited (Pharmaceutical company). Phase: Phase I and Phase II (Integrated)- First administration to humans. Countries: Belgium (ongoing, recruiting), Spain (ongoing, recruiting).
Therapeutic area(s): Diseases [C] - Virus Diseases [C02]
Gender: Female, Male. Age: 18-64 years, 65+ years. Enrolment: 20.
Status: Ongoing, recruiting. Start date (EU): 2022-04-06. Decision date: 2024-08-12. Results received: No. Last updated: 2026-07-22.
Decision dates by country: BE: 2024-08-13, ES: 2024-08-12

Condition(s): Chronic HIV infection
Product: IMC-M113V

Primary endpoint: • Incidence and severity of treatment-emergent adverse events (TEAEs) • Incidence of dose-limiting toxicities (DLTs) • Changes in safety laboratory parameters, vital signs, and electrocardiogram (QTcF) • Incidence of serious adverse events (SAEs) and AEs leading to treatment interruption, dose reduction, or discontinuation through 28 days after the last infusion of study treatment
Endpoint(s): IMC-M113V pharmacokinetics (PK) parameters (eg, AUC, Cmax, Tmax, t1/2) at multiple time points from baseline up to 72 hours post-dose in SAD and MAD (first dose) and after each subsequent dose in MAD studies Incidence of anti-IMC-M113V antibody formation following administration of one or more doses of study drug, Change in serum cytokines/chemokines and peripheral blood lymphocyte counts (absolute values and fold-change) from baseline through 72 hours post-dosing with IMC-M113V in SAD and MAD schedules and during Follow-Up., • Proportion of participants with pVL < 200 copies/mL 12 weeks after interruption of ART (W24) • Proportion of participants resuming ART before W24 • Duration of post-treatment control (pVL < 200 copies/mL) after interruption of ART • Duration of virological suppression (pVL <1000 copies/mL) after interruption of ART Identification of at least 1 tolerable dosing regimen for further evaluation in subsequent development

Source: https://euclinicaltrials.eu/ctis-public/view/2024-513938-38-00